EU clinical trial 2023-504735-41-00: A Phase 3, Multicenter, Randomized, Platform Study of p19 Inhibition of the IL-23 Pathway to Establish Efficacy in Pediatric Crohn’s Disease
Protocol code: CNTO1959PBCRD3007
Sponsor: Janssen - Cilag International (Pharmaceutical company). Phase: Therapeutic confirmatory (Phase III). Countries: Portugal (ongoing, recruiting), Netherlands (ongoing, recruiting), France (ongoing, recruiting), Norway (ongoing, recruiting), Poland (ongoing, recruiting), Austria (ongoing, recruiting), Belgium (ongoing, recruiting), Spain (ongoing, recruiting), Italy (ongoing, recruiting).
Therapeutic area(s): Diseases [C] - Digestive System Diseases [C06]
Gender: Female, Male. Age: 0-17 years. Enrolment: 30.
Status: Ongoing, recruiting. Start date (EU): 2024-03-05. Decision date: 2024-08-13. Results received: No. Last updated: 2026-07-27.
Decision dates by country: PL: 2024-08-30, AT: 2024-09-29, PT: 2024-08-16, NL: 2024-08-13, ES: 2024-08-27, BE: 2024-08-20, FR: 2024-09-04, IT: 2024-09-24, NO: 2024-08-20

Condition(s): Moderately to Severely Active Crohn's Disease
Product: Guselkumab, Placebo 2.0ml equivalent, Guselkumab, Guselkumab - solution for injection in pre-filled syringe - 100 mg/mL, Placebo 0.5ml equivalent, Guselkumab- Solution for infusion- 10 mg/ml, Placebo 1.0ml equivalent

Primary endpoint: Clinical remission at Week 52 (defined as PCDAI score ≤10), Endoscopic response (≥50% reduction from SES-CD score at baseline) at Week 52

Source: https://euclinicaltrials.eu/ctis-public/view/2023-504735-41-00